EU clinical trial 2025-524918-28-00: A Randomized, Double-Blind, Placebo-Controlled Study to Investigate the Efficacy and Safety of SIR9900 in Patients with VEXAS Syndrome (SIVEX)
Protocol code: SIR9900-GLB-202
Sponsor: Sironax USA Inc. (Pharmaceutical company). Phase: Therapeutic exploratory (Phase II). Countries: Italy (authorised, recruitment pending).
Therapeutic area(s): Diseases [C] - Immune System Diseases [C20]
Gender: Female, Male. Age: 18-64 years, 65+ years. Enrolment: 24.
Status: Authorised, recruitment pending. Decision date: 2026-07-23. Results received: No. Last updated: 2026-07-23.

Condition(s): VEXAS Syndrome
Product: SIR9900 10mg, Sir9900 Placebo

Primary endpoint: Part A, Dose Ranging Study: Incidence and severity of Treatment-Emergent Adverse Events (TEAEs), Serious Adverse Events (SAEs), and clinically significant laboratory abnormalities; Proportion of participants with Early Treatment Failure defined as the inability to taper GC to ≤10 mg/day, early termination before OCR or the occurrence of a protocol-defined flare. Part B, Efficacy and Safety Study: Proportion of participants achieving OCR up to end of week 24.
Endpoint(s): Mean plasma conc. of SIR9900 at week 1, 12, 24, 48, 52; CRP, ESR, Ferritin up to end of week 52 Proportion of pts with OCR up to end of week 24: Incidence and severity of AEs and SAEs, death; Clinically significant abnormalities, vital signs, laboratory tests, 12-lead ECGs; Cumulative GC dose; Proportion of pts with each best response category; Nr of flare-free days with GC dose ≤10 mg/day; Erythroid (HI-E) at any time among pts with baseline hemoglobin <10 g/dL and Platelets (HI-P) at any t

Source: https://euclinicaltrials.eu/ctis-public/view/2025-524918-28-00